EU clinical trial 2024-517005-85-00: A multicentre clinical trial evaluating the safety and efficacy of the combination of nintedanib and tocilizumab compared to standard treatment in patients with systemic sclerosis and interstitial lung disease. Analysis with theranostic approach and assessment of cytokine activity, markers of inflammation and pulmonary fibrosis using computed tomography, positron emission tomography, and metabolome and transcriptome studies in selected patients. NINTOC-TU study
Protocol code: NIGRIR_004NINTOC-TU
Sponsor: Narodowy Instytut Geriatrii Reumatologii I Rehabilitacji Im Prof. Dr Hab. Med. Eleonory Reicher (Hospital/Clinic/Other health care facility). Phase: Therapeutic confirmatory (Phase III). Countries: Poland (ended).
Therapeutic area(s): Diseases [C] - Skin and Connective Tissue Diseases [C17]
Gender: Female, Male. Age: 18-64 years, 65+ years. Enrolment: 86.
Status: Ended. Start date (EU): 2025-07-01. End date (EU): 2026-03-23. Decision date: 2024-10-16. Results received: No. Last updated: 2024-10-16.

Condition(s): systemic sclerosis with interstitial lung disease (ILD) in the course of the disease
Product: RoActemra 162 mg solution for injection in pre-filled syringe., Ofev 100 mg soft capsules, RoActemra 162 mg solution for injection in pre-filled syringe., Ofev 150 mg soft capsules, Ofev 150 mg soft capsules, Ofev 100 mg soft capsules

Primary endpoint: Decrease in forced vital capacity of the lungs FVC expressed in ml calculated after 56 weeks of treatment.
Endpoint(s): Change from baseline in percent lung involvement as assessed by computed tomography (HRCT%) after 56 weeks of study., Evaluation of absolute changes in DLCO at week 56 from baseline., Evaluation of absolute changes from baseline in FVC% at 56 weeks., Change from baseline in the 6MWT test at week 56., Change in the Health Assessment Questionnaire-Disability Index (HAQ-DI) score at week 56., Change in Patient's Global Assessment - PtGA (Physician's Global Assessment - PtGA) of disease activity by the patient and physician at week 56., Evaluation of absolute changes from baseline in the total score of the St. George's Respiratory Questionnaire (SGRQ) at 56 weeks., Evaluation of absolute changes from baseline in Modified Rodnan Skin Induration Score (mRSS) at Week 56., Percentage of participants with threshold mRSS improvement from baseline at Week 56., Percentage of participants with mRSS improvement greater than or equal to (> / =) 20%, 40% or 60% [time frame: baseline visit to week 56].

Source: https://euclinicaltrials.eu/ctis-public/view/2024-517005-85-00